EU clinical trial 2024-515968-32-00: Randomized non-inferiority clinical trial to evaluate the efficacy of a single fixed dose of 18 mg ivermectin for the treatment of uncomplicated strongyloidiasis.
Protocol code: STRONG-FIX
Sponsor: Fundacio Hospital Universitari Vall D’Hebron Institut De Recerca (Laboratory/Research/Testing facility). Phase: Therapeutic exploratory (Phase II). Countries: Spain (ongoing, recruiting).
Therapeutic area(s): Diseases [C] - Parasitic Diseases [C03]
Gender: Female, Male. Age: 18-64 years, 65+ years. Enrolment: 276.
Status: Ongoing, recruiting. Start date (EU): 2025-04-08. Decision date: 2024-07-22. Results received: No. Last updated: 2025-12-05.

Condition(s): Strongyloidiasis is caused by a parasite that is globally distributed in tropical and sub-tropical areas. Most patients with strongyloidiasis are asymptomatic or have mild symptoms with gastrointestinal disturbances, respiratory symptoms, and skin lesions. In situations of low defenses (patients under treatment with corticosteroids, organ transplant recipients or other situations) they can present serious complications with high mortality.
Product: IVERMECTIN

Primary endpoint: Proportion of patients with microbiological cure at 6 months of treatment.

Source: https://euclinicaltrials.eu/ctis-public/view/2024-515968-32-00